EU clinical trial 2023-507698-16-00: A Phase 3 Open-Label, Randomized Study of Fixed Duration Pirtobrutinib (LOXO-305) plus Venetoclax and Rituximab versus Venetoclax and Rituximab in Previously Treated Chronic Lymphocytic Leukemia/Small Lymphocytic Lymphoma (BRUIN CLL-322)
Protocol code: LOXO-BTK-20022
Sponsor: Loxo Oncology Inc. (Pharmaceutical company). Phase: Therapeutic confirmatory (Phase III). Countries: Hungary (ongoing, recruitment ended), Sweden (ongoing, recruitment ended), Belgium (ongoing, recruitment ended), France (ongoing, recruitment ended), Ireland (ongoing, recruitment ended), Czechia (ongoing, recruitment ended), Denmark (ongoing, recruitment ended), Spain (ongoing, recruitment ended), Germany (ongoing, recruitment ended), Poland (ongoing, recruitment ended), Italy (ongoing, recruitment ended).
Therapeutic area(s): Diseases [C] - Neoplasms [C04]
Gender: Female, Male. Age: 18-64 years, 65+ years. Enrolment: 262.
Status: Ongoing, recruitment ended. Start date (EU): 2021-10-14. Decision date: 2024-06-12. Results received: No. Last updated: 2026-08-07.
Decision dates by country: BE: 2024-06-17, PL: 2024-07-01, HU: 2024-06-12, FR: 2024-06-17, CZ: 2024-06-13, IT: 2024-07-01, ES: 2024-06-17, DE: 2024-06-13, SE: 2024-06-12, IE: 2024-06-14, DK: 2024-06-14

Condition(s): Chronic Lymphocytic Leukemia/Small Lymphocytic Lymphoma (BRUIN CLL-322)
Product: PIRTOBRUTINIB, VENETOCLAX, VENETOCLAX, RITUXIMAB, PIRTOBRUTINIB

Primary endpoint: PFS per International Workshop on Chronic Lymphocytic Leukemia (iwCLL) Criteria 2018, assessed by Independent Review Committee (IRC)

Source: https://euclinicaltrials.eu/ctis-public/view/2023-507698-16-00